EU clinical trial 2024-510730-40-00: A Phase 3 Multicenter, Randomized, Double-Blind Placebo-Controlled Study to Evaluate the Efficacy and Safety of Lutikizumab (ABT-981) in Adult and Adolescent Subjects with Moderate to Severe Hidradenitis Suppurativa
Protocol code: M20-465
Sponsor: AbbVie Deutschland GmbH & Co. KG (Pharmaceutical company). Phase: Therapeutic confirmatory (Phase III). Countries: Poland (ongoing, recruitment ended), Sweden (ongoing, recruitment ended), Slovakia (ongoing, recruitment ended), Belgium (ongoing, recruitment ended), Greece (ongoing, recruitment ended), Romania (ongoing, recruitment ended), Norway (ongoing, recruitment ended), Portugal (ongoing, recruitment ended), Croatia (ongoing, recruitment ended), France (ongoing, recruitment ended), Denmark (ongoing, recruitment ended), Bulgaria (ongoing, recruitment ended), Spain (ongoing, recruitment ended), Ireland (ongoing, recruitment ended), Hungary (ongoing, recruitment ended), Austria (ongoing, recruitment ended), Czechia (ongoing, recruitment ended), Slovenia (ongoing, recruitment ended), Germany (ongoing, recruitment ended), Italy (ongoing, recruitment ended), Netherlands (ongoing, recruitment ended), Lithuania (ongoing, recruitment ended).
Therapeutic area(s): Diseases [C] - Skin and Connective Tissue Diseases [C17]; Diseases [C] - Immune System Diseases [C20]
Gender: Female, Male. Age: 0-17 years, 18-64 years, 65+ years. Enrolment: 500.
Status: Ongoing, recruitment ended. Start date (EU): 2024-12-12. Decision date: 2024-11-05. Results received: No. Last updated: 2026-07-20.
Decision dates by country: SI: 2024-11-06, SK: 2024-11-11, SE: 2024-11-07, AT: 2024-11-08, CZ: 2024-11-11, GR: 2024-11-05, IE: 2024-11-08, HR: 2024-11-11, HU: 2024-11-07, DK: 2024-11-06, NL: 2024-11-05, DE: 2024-11-08, LT: 2025-12-22, NO: 2024-11-07, PT: 2024-11-06, RO: 2024-11-11, ES: 2024-11-11, IT: 2024-11-11, PL: 2024-11-11, FR: 2024-11-08, BE: 2024-11-05, BG: 2024-11-11

Condition(s): Hidradenitis Suppurativa
Product: Lutikizumab, Placebo of Lutikizumab

Primary endpoint: The primary endpoint is the achievement of HiSCR 75 at Week 16. HiSCR 75 is defined as at least a 75% reduction from baseline in the total AN count, with no increase in abscess count and no increase in draining fistula count relative to baseline.
Endpoint(s): Ranked Secondary Endpoints: Achievement of NRS30 (at least a 30% reduction and at least 2-units reduction from Baseline in the Patient's Global Assessment of HS-related skin pain NRS) at Week 8 among subjects with NRS ≥ 3 at Baseline. The NRS30 is based on worst skin pain in a 24-hour recall period (maximal daily pain); ", Change from Baseline in DLQI at Week 16 among subjects ≥ 16 years of age at Baseline;, Change from Baseline in HSIA at Week 16, Change from Baseline in HSSA Worst Drainage Score at Week 16;, Change from Baseline in Draining Fistula at Week 16 among subjects with at least 1 draining fistula at Baseline;, Achievement of HiSCR 90 (at least a 90% reduction in the total AN count with no increase in abscess count and no increase in draining fistula count relative to Baseline) at Week 16;, Change from Baseline in the Patient's Global Assessment of HS-related Skin Pain (NRS) at Week 8;, Change from Baseline in HSSA at Week 16;, Change from Baseline in HS-related odor (smell), based on HSSA Question 8, at Week 16;, Occurrence of HS flare, defined as at least one occurrence of a ≥ 25% increase in AN count with a minimum absolute increase of 2 relative to Baseline during the first 16 weeks (Period 1)., Change from Baseline in HSIA Emotional Domain at Week 16;, Change from Baseline in HSIA Mobility Domain at Week 16.

Source: https://euclinicaltrials.eu/ctis-public/view/2024-510730-40-00